EU clinical trial 2023-506719-17-00: A Dose Finding Study of [177Lu]Lu-DOTA-TATE in Newly Diagnosed Glioblastoma in Combination with Standard of Care and in Recurrent Glioblastoma as a Single Agent.
Protocol code: CAAA601A52101
Sponsor: Novartis Pharma AG (Pharmaceutical company). Phase: Human Pharmacology (Phase I)- Other. Countries: France (ongoing, recruitment ended), Spain (ended), Portugal (ended).
Therapeutic area(s): Diseases [C] - Neoplasms [C04]
Gender: Female, Male. Age: 18-64 years, 65+ years. Enrolment: 34.
Start date (EU): 2022-05-10. Decision date: 2024-05-23. Results received: No. Last updated: 2026-05-26.
Decision dates by country: FR: 2024-05-28, ES: 2024-05-23, PT: 2024-05-23

Condition(s): Glioblastoma

Source: https://euclinicaltrials.eu/ctis-public/view/2023-506719-17-00